EU clinical trial 2024-516615-25-00: A first-in-human study to learn about the safety of BAY 3547926 and how well it works in participants with advanced liver cancer
Protocol code: 22262
Sponsor: Bayer Consumer Care AG, Bayer AG (Pharmaceutical company). Phase: Human Pharmacology (Phase I)- First administration to humans. Countries: Spain (ongoing, recruiting), Belgium (ongoing, recruiting), Finland (ongoing, recruiting), France (ongoing, recruiting).
Therapeutic area(s): Diseases [C] - Neoplasms [C04]
Gender: Female, Male. Age: 18-64 years, 65+ years. Enrolment: 123.
Status: Ongoing, recruiting. Start date (EU): 2025-05-14. Decision date: 2025-04-08. Results received: No. Last updated: 2026-07-10.
Decision dates by country: ES: 2025-04-16, FI: 2025-04-08, BE: 2025-04-08, FR: 2025-10-31

Condition(s): hepatocellular carcinoma (HCC)

Source: https://euclinicaltrials.eu/ctis-public/view/2024-516615-25-00